EU clinical trial 2023-506561-62-00: Bioequivalence clinical trial of two formulations of dapagliflozin.
Protocol code: N-DAP-23-281
Sponsor: Laboratorios Normon S.A. (Pharmaceutical company). Phase: Human Pharmacology (Phase I)- Bioequivalence Study. Countries: Spain (ended).
Therapeutic area(s): Not possible to specify
Gender: Female, Male. Age: 18-64 years. Enrolment: 30.
Status: Ended. Start date (EU): 2024-07-01. End date (EU): 2024-08-05. Decision date: 2024-06-24. Results received: No. Last updated: 2024-06-24.

Condition(s): Healthy volunteers

Source: https://euclinicaltrials.eu/ctis-public/view/2023-506561-62-00